EU clinical trial 2023-506914-32-00: Pan Tumor Study for Long-term Treatment of Cancer Patients Who Have Participated in BMS sponsored Trials Investigating Nivolumab and Other Cancer Therapies
Protocol code: CA209-8TT
Sponsor: Bristol-Myers Squibb Services Unlimited Company (Pharmaceutical company). Phase: Therapeutic exploratory (Phase II). Countries: Poland (ongoing, recruiting), Romania (ongoing, recruiting), Austria (ongoing, recruiting), Italy (ongoing, recruiting), Czechia (ongoing, recruiting), Belgium (ongoing, recruiting), Spain (ongoing, recruiting), Germany (ongoing, recruiting), Greece (ongoing, recruiting), France (ongoing, recruiting).
Therapeutic area(s): Diseases [C] - Neoplasms [C04]
Gender: Female, Male. Age: 18-64 years, 65+ years. Enrolment: 307.
Status: Ongoing, recruiting. Start date (EU): 2020-05-05. Decision date: 2024-06-05. Results received: No. Last updated: 2026-07-15.
Decision dates by country: BE: 2024-06-05, PL: 2024-06-05, CZ: 2024-06-10, ES: 2024-06-07, GR: 2024-08-22, DE: 2024-06-12, RO: 2024-06-10, FR: 2024-06-24, AT: 2024-06-09, IT: 2024-06-17

Condition(s): Pan tumor
Product: KEYTRUDA 25 mg/mL concentrate for solution for infusion, Sutent 50 mg hard capsules, TEMOZOLOMIDE, ALIMTA 500 mg powder for concentrate for solution for infusion, Capecitabine Accord 150 mg film-coated tablets, Capecitabine Accord 500 mg film-coated tablets, SUNITINIB, TEMOZOLOMIDE, Sutent 12.5 mg hard capsules, Capecitabine Accord 300 mg film-coated tablets, Rubraca 200 mg film-coated tablets, TEMOZOLOMIDE, Sutent 25 mg hard capsules, Mekinist 0.5 mg film-coated tablets, REGORAFENIB, Sutent 50 mg hard capsules, Temozolomide SUN 20 mg hard capsules, Fluorouracil 50 mg/ml Solution for Injection or Infusion, YERVOY 5 mg/ml concentrate for solution for infusion, OPDIVO 10 mg/mL concentrate for solution for infusion., Nivolumab/Relatlimab, DARZALEX 20 mg/mL concentrate for solution for infusion, Sutent 25 mg hard capsules, CABOMETYX 20 mg film-coated tablets, OPDIVO 10 mg/mL concentrate for solution for infusion., Capecitabine Accord 300 mg film-coated tablets, Xtandi 40 mg soft capsules, Capecitabine Accord 300 mg film-coated tablets, Temozolomide SUN 5 mg hard capsules, Temozolomide SUN 140 mg hard capsules, Capecitabine Accord 150 mg film-coated tablets, Capecitabine Accord 150 mg film-coated tablets, Temozolomide SUN 250 mg hard capsules, PEMETREXED, YERVOY 5 mg/ml concentrate for solution for infusion, Relatlimab, CABOZANTINIB, SUNITINIB, SUNITINIB, CAPECITABINE, Temozolomide SUN 100 mg hard capsules, Capecitabine Accord 500 mg film-coated tablets, Capecitabine Accord 500 mg film-coated tablets, Stivarga 40 mg film-coated tablets, Sutent 12.5 mg hard capsules, Avastin 25 mg/ml concentrate for solution for infusion., Capecitabine Accord 150 mg film-coated tablets, Temozolomide SUN 140 mg hard capsules, Temozolomide SUN 250 mg hard capsules, BEVACIZUMAB, RUCAPARIB, Temozolomide SUN 5 mg hard capsules, TEMOZOLOMIDE, PEMETREXED, RUCAPARIB, Avastin 25 mg/ml concentrate for solution for infusion., Capecitabine Accord 300 mg film-coated tablets, Capecitabine Accord 300 mg film-coated tablets, Mekinist 2 mg film-coated tablets, Temozolomide SUN 180 mg hard capsules, Capecitabine Accord 300 mg film-coated tablets, SUNITINIB, Temozolomide SUN 180 mg hard capsules, Rubraca 250 mg film-coated tablets, CABOMETYX 40 mg film-coated tablets, CAPECITABINE, TRAMETINIB, DARATUMUMAB, Rubraca 300 mg film-coated tablets, Capecitabine Accord 500 mg film-coated tablets, TEMOZOLOMIDE, Sodiofolin 50 mg/ml, solution for injection/infusion, Temozolomide SUN 20 mg hard capsules, CABOZANTINIB, TRAMETINIB, TEMOZOLOMIDE, Capecitabine Accord 500 mg film-coated tablets, PEMBROLIZUMAB, Capecitabine Accord 500 mg film-coated tablets, CAPECITABINE, OXALIPLATIN, Capecitabine Accord 150 mg film-coated tablets, Mekinist 0.5 mg film-coated tablets, Capecitabine Accord 150 mg film-coated tablets, ENZALUTAMIDE, Oxaliplatin 5 mg/ml concentrate for solution for infusion, Sutent 37.5 mg hard capsules, BEVACIZUMAB, DARZALEX 20 mg/mL concentrate for solution for infusion, Relatlimab, Stivarga 40 mg film-coated tablets, Temozolomide SUN 100 mg hard capsules, RUCAPARIB, Sutent 37.5 mg hard capsules, DISODIUM FOLINATE, FLUOROURACIL, Mekinist 2 mg film-coated tablets, ALIMTA 100 mg powder for concentrate for solution for infusion

Primary endpoint: Incidence of adverse events (including related AEs, AEs leading to discontinuation, SAEs, select AEs, immune-mediated AEs, and deaths).
Endpoint(s): OS defined as date of randomization, first dose, or as defined in the Parent Study until date of death from any cause or censored on the last known alive date in the rollover study, Incidence of AEs.

Source: https://euclinicaltrials.eu/ctis-public/view/2023-506914-32-00